EU clinical trial 2024-512463-31-00: Phase I trial with 177Lu-DOTA-TATE and olaparib in somatostatin receptor positive tumours
Sponsor: Vaestra Goetalandsregionen (Hospital/Clinic/Other health care facility). Phase: Human Pharmacology (Phase I)- Other. Countries: Sweden (ongoing, recruitment ended).
Therapeutic area(s): Diseases [C] - Neoplasms [C04]
Gender: Female, Male. Age: 18-64 years, 65+ years. Enrolment: 18.
Status: Ongoing, recruitment ended. Start date (EU): 2024-10-27. Decision date: 2024-10-23. Results received: No. Last updated: 2024-10-23.

Condition(s): Somatostatin receptor positive tumours

Source: https://euclinicaltrials.eu/ctis-public/view/2024-512463-31-00